EU clinical trial 2024-520146-33-00: Intrathecal contrast-enhanced MRI for investigation of cerebrospinal fluid transportation
Sponsor: Region Vaesterbotten (Hospital/Clinic/Other health care facility). Phase: Phase I and Phase II (Integrated)- Other. Countries: Sweden (ongoing, recruiting).
Therapeutic area(s): Diseases [C] - Nervous System Diseases [C10]
Gender: Female, Male. Age: 18-64 years, 65+ years. Enrolment: 135.
Status: Ongoing, recruiting. Start date (EU): 2025-01-13. Decision date: 2025-01-13. Results received: No. Last updated: 2026-07-23.

Condition(s): Cerebrospinal fluid circulation disorder seen in clinically suspected idiopathic normal pressure hydrocephalus, Alzheimers Disease and healthy controls.
Product: VIZAMYL 400 MBq/mL solution for injection, Gadovist 1.0 mmol/ml solution for injection

Primary endpoint: Time-dependent change in signal intensity on brain MRI after intrathecal contrast administration will be analyzed with indicator dilution algorthim that will be optimized using computational fluid dynamic simulations., Registration of possible adverse events related to the intrathecal injection of Gadovist
Endpoint(s): Comparision between the distribution of the contrast and other MRI-sequences and cerebrospinal fluid dynamic parameters which provides us with information regarding possible driving mechanisms for the distribution., Quantified pre-operative glymphatic function will be correlated to clinical improvment after CSF shunting of INPH patients, Quantified pre-operative glymphatic function will be correlated to clinical progress and beta-amyloid content in HC and AD-patients.

Source: https://euclinicaltrials.eu/ctis-public/view/2024-520146-33-00